EU clinical trial 2024-517048-67-00: Positron emission tomography (PET) of patients with brain injury and athletes with concussion symptoms - Descriptive study of the tau tracer 18F-RO6958948
Protocol code: RS200511
Sponsor: Region Skane (Hospital/Clinic/Other health care facility). Phase: Therapeutic exploratory (Phase II). Countries: Sweden (ongoing, recruiting).
Therapeutic area(s): Analytical, Diagnostic and Therapeutic Techniques and Equipment [E] - Diagnosis [E01]
Gender: Female, Male. Age: 18-64 years. Enrolment: 80.
Status: Ongoing, recruiting. Start date (EU): 2021-04-21. Decision date: 2024-09-20. Results received: No. Last updated: 2024-09-20.

Condition(s): Cerebral commotio, Intracerebral hemorrhage (ICH), Traumatic brain injury (TBI), Subarachnoid hemorrhage (SAH)

Primary endpoint: Uptake of the PETtracer measured at PET examination.

Source: https://euclinicaltrials.eu/ctis-public/view/2024-517048-67-00